EU clinical trial 2025-522000-24-00: A Phase 1B, Open-Label Study of Mirdametinib in Infants and Toddlers with Neurofibromatosis Type 1 associated Plexiform Neurofibromas
Protocol code: MEK-NF1-104
Sponsor: Springworks Therapeutics Inc. (Pharmaceutical company). Phase: Human Pharmacology (Phase I)- Other. Countries: Spain (authorised, recruitment pending), Germany (authorised, recruitment pending).
Therapeutic area(s): Diseases [C] - Neoplasms [C04]; Diseases [C] - Congenital, Hereditary, and Neonatal Diseases and Abnormalities [C16]
Gender: Female, Male. Age: 0-17 years. Enrolment: 8.
Status: Authorised, recruitment pending. Decision date: 2025-11-26. Results received: No. Last updated: 2026-06-26.
Decision dates by country: DE: 2025-12-19, ES: 2025-11-27

Condition(s): Neurofibromatosis Type 1 (NF1) Associated Plexiform Neurofibromas (PN)
Product: Mirdametinib

Primary endpoint: Key safety endpoints will include incidence of TEAEs, changes in laboratory parameters, vital signs, physical examination findings and electrocardiograms (ECGs), echocardiogram (ECHO), and ophthalmic exam findings, The severity of all AEs will be graded according to the National Cancer Institute Common Terminology Criteria for Adverse Events (NCI CTCAE) v5.0., PK parameters, such as Cmin, Cmax, and AUC at steady state.
Endpoint(s): Confirmed ORR (defined as PN decrease ≥20% compared to baseline in consecutive scans within 2 to 6 months) using centrally read MRI volumetric analyses by a Blinded Independent Central Review (BICR)., DoR, defined as the time from onset of confirmed complete response (CR) + partial response (PR) using centrally read MRI volumetric analysis by a BICR to the earliest event of progressive disease (PD) or death., Change from baseline in QoL assessed by the age-specific Paediatric Quality of Life Inventory (PedsQL) Infant Scales., Change from baseline pain assessment by age-specific pain scale: faces, legs, activity, cry, consolability (FLACC)

Source: https://euclinicaltrials.eu/ctis-public/view/2025-522000-24-00